EU clinical trial 2023-507475-21-00: A RANDOMIZED, OPEN LABEL PHASE 2/3 STUDY COMPARING COBOLIMAB + DOSTARLIMAB + DOCETAXEL TO DOSTARLIMAB + DOCETAXEL TO DOCETAXEL ALONE IN PARTICIPANTS WITH ADVANCED NONSMALL CELL LUNG CANCER WHO HAVE PROGRESSED ON PRIOR ANTI PD (L)1 THERAPY AND CHEMOTHERAPY (COSTAR LUNG)
Protocol code: 213410
Sponsor: Glaxosmithkline Research & Development Limited (Pharmaceutical company). Phase: Phase II and Phase III (Integrated). Countries: Belgium (ended), France (ongoing, recruitment ended), Greece (ongoing, recruitment ended), Italy (ended), Finland (ended), Netherlands (ongoing, recruitment ended), Sweden (ended), Spain (ongoing, recruitment ended), Poland (ongoing, recruitment ended), Germany (ongoing, recruitment ended), Romania (ongoing, recruitment ended).
Therapeutic area(s): Diseases [C] - Neoplasms [C04]
Gender: Female, Male. Age: 18-64 years, 65+ years. Enrolment: 440.
Start date (EU): 2021-01-18. Decision date: 2024-02-21. Results received: No. Last updated: 2026-07-06.
Decision dates by country: SE: 2024-02-22, BE: 2024-04-03, FI: 2024-02-22, GR: 2024-04-08, PL: 2024-03-15, ES: 2024-02-21, RO: 2024-02-26, NL: 2024-02-22, IT: 2024-02-23, FR: 2024-02-22, DE: 2024-02-26

Condition(s): Lung Cancer, Non-Small Cell
Product: Docetaxel Hikma 20 mg/1 ml Konzentrat zur Herstellung einer Infusionslösung, Docetaxel Hikma 80 mg/4 ml Konzentrat zur Herstellung einer Infusionslösung, Docetaxel Hikma 160 mg/8 ml Konzentrat zur Herstellung einer Infusionslösung, JEMPERLI 500 mg concentrate for solution for infusion

Primary endpoint: " Efficacy of triplet compared to docetaxel alone-OS defined as survival from the date of randomization to the date of death by any cause. ", " Efficacy of doublet compared to docetaxel alone-OS defined as survival from the date of randomization to the date of death by any cause. "
Endpoint(s): "Efficacy of the triplet relative to the doublet-OS defined as survival from the date of randomization to the date of death by any cause. ", "The study will compare Arm A vs Arm C, Arm B vs Arm C and Arm A vs. Arm B using the following endpoints: - Confirmed ORR -PFS -DOR -TTD -Change from baseline as assessed by the EORTC-QLQ-C30 and the EORTC-QLQ-LC13 domains ", "The study will evaluate the safety and tolerability of Arm A and Arm B vs docetaxel alone using the following endpoints: - The incidence of TEAEs, SAEs, irAEs, TEAEs leading to death, and AEs leading to discontinuation occurring while participants are on treatment or up to 90 days after the last dose of study treatment."

Source: https://euclinicaltrials.eu/ctis-public/view/2023-507475-21-00